EU clinical trial 2025-521973-16-00: A PHASE 1/1B STUDY TO EVALUATE THE SAFETY, TOLERABILITY, PHARMACOKINETICS, AND IMMUNOGENICITY OF SINGLE AND MULTIPLE ASCENDING DOSES OF BCX17725 IN HEALTHY PARTICIPANTS AND MULTIPLE DOSES OF BCX17725 IN PARTICIPANTS WITH NETHERTON SYNDROME
Protocol code: BCX17725-101
Sponsor: Biocryst Pharmaceuticals Inc. (Pharmaceutical company). Phase: Phase I and Phase II (Integrated)- Other. Countries: France (ongoing, recruiting), Netherlands (ongoing, recruiting), Germany (authorised, recruitment pending).
Therapeutic area(s): Diseases [C] - Skin and Connective Tissue Diseases [C17]
Gender: Female, Male. Age: 0-17 years, 18-64 years. Enrolment: 6.
Start date (EU): 2026-03-31. Decision date: 2026-01-20. Results received: No. Last updated: 2026-06-10.
Decision dates by country: NL: 2026-01-20, FR: 2026-01-23, DE: 2026-01-21

Condition(s): Netherton Syndrome
Product: BCX17725

Primary endpoint: Effectiveness : Primary Effectiveness Endpoint: • Change from baseline in Ichthyosis Area and Severity Index (IASI) score at Week 12, Safety : Incidence of TEAEs through End-of-Study (EOS), PK : Concentration of BCX17725 in serum through EOS
Endpoint(s): Effectiveness : Key Secondary Effectiveness Endpoints: • Change from baseline in Investigator Global Assessment (IGA) score at Week 12 Change from baseline in the Worst Itch Numerical Rating Scale (NRS) score at Week 12

Source: https://euclinicaltrials.eu/ctis-public/view/2025-521973-16-00